EU clinical trial 2025-524541-27-00: THRILL: Treat Hyperinflammation in child oncology study - A single arm, historically controlled, open label phase II study on the efficacy and safety of the recombinant interleukin (IL)-1R antagonist anakinra in pediatric cancer patients admitted to the intensive care with sepsis and signs of hyperinflammation
Protocol code: MB24THR
Sponsor: Prinses Maxima Centrum voor Kinderoncologie B.V. (Hospital/Clinic/Other health care facility). Phase: Therapeutic exploratory (Phase II). Countries: Netherlands (authorised, recruitment pending).
Therapeutic area(s): Diseases [C] - Immune System Diseases [C20]; Diseases [C] - Neoplasms [C04]
Gender: Female, Male. Age: 0-17 years. Enrolment: 76.
Status: Authorised, recruitment pending. Decision date: 2026-05-18. Results received: No. Last updated: 2026-07-02.

Condition(s): Sepsis, Hyperinflammation
Product: ANAKINRA

Primary endpoint: The difference in 28-day all-cause mortality between the early anakinra + SoC and historical SoC group.
Endpoint(s): Adverse events (AEs), as characterized by type, frequency, severity (as graded using CTCAE v5.0), ≥ grade 3 liver enzyme abnormalities (ALT, bilirubin), The cumulative incidence of secondary infections., The difference in cumulative Phoenix-8 organ dysfunction score over three days between the early anakinra + SoC and historical SoC group., The difference in cumulative Phoenix-8 organ dysfunction score over seven days between the early anakinra + SoC and historical SoC group., The difference in ICU mortality between the early anakinra + SoC and historical SoC group., The comparison of the two groups of treatment on: - the number of ventilator-free days at day 28 - the number of vasoactive medication-free days at day 28 - the highest VIS score - the cumulative VIS score over seven days - the requirement of CRRT - the requirement of ECMO, The comparison of the two groups of treatment on ICU LOS.

Source: https://euclinicaltrials.eu/ctis-public/view/2025-524541-27-00